EU clinical trial 2022-500764-35-00: CAPTOR-BC: COMPREHENSIVE ANALYSIS OF SPATIAL, TEMPORAL AND MOLECULAR PATTERNS OF RIBOCICLIB EFFICACY AND RESISTANCE IN ADVANCED BREAST CANCER PATIENTS
Protocol code: IFG-01-2022
Sponsor: Institut Für Frauengesundheit GmbH (Hospital/Clinic/Other health care facility). Phase: Therapeutic use (Phase IV). Countries: Germany (ongoing, recruiting).
Therapeutic area(s): Diseases [C] - Neoplasms [C04]
Gender: Female. Age: 18-64 years, 65+ years. Enrolment: 2000.
Status: Ongoing, recruiting. Start date (EU): 2022-10-13. Decision date: 2022-10-12. Results received: No. Last updated: 2026-06-17.

Condition(s): Patients with advanced HER2-negative, hormone receptor positive (HER2neg/HR+) breast cancer in the first line therapeutic setting
Product: ANASTROZOLE, FULVESTRANT, LETROZOLE, EXEMESTANE, RIBOCICLIB

Primary endpoint: progression-free survival, overall survival
Endpoint(s): progression-free survival, overall survival, health related quality of life FACT-G/FACT-B, occurence of side effects

Source: https://euclinicaltrials.eu/ctis-public/view/2022-500764-35-00